EU clinical trial 2024-517234-18-00: Nitrous oxide detection - A study in healthy volunteers to help victims of nitrous oxide related crimes
Sponsor: Aarhus Universitet (Educational Institution). Phase: Human Pharmacology (Phase I)- Other. Countries: Denmark (ended).
Therapeutic area(s): Diseases [C] - Nervous System Diseases [C10]
Gender: Female, Male. Age: 18-64 years. Enrolment: 30.
Status: Ended. End date (EU): 2025-10-08. Decision date: 2024-10-22. Results received: No. Last updated: 2025-01-10.

Condition(s): Nitrous oxide intoxication
Product: PARACETAMOL, OXYGEN, NITROUS OXIDE

Primary endpoint: Time from end of inhalation of study medication to N2O-concentration in blood is no longer statistically significantly increased in the active treatment group compared to the placebo group
Endpoint(s): Time until N2O-concentration in exhaled breath is no longer statistically significantly increased in the active treatment group compared to the placebo group, Time until N2O-concentration in oral fluid and urine is no longer statistically significantly increased in the active treatment group compared to the placebo group., Time until N2O screening breathalyzer is no longer capable of N2O detection., Time until the longest detectable possible biomarker in blood or urine is no longer up- or downregulated in the active treatment group compared to the placebo group., Time until formiminoglutamic acid is no longer statistically significantly increased in the active treatment group compared to the and placebo group., Verifying that concentration of N2O and possible biomarkers can detected by routine screening at Department of Forensic Medicine, Aarhus University.

Source: https://euclinicaltrials.eu/ctis-public/view/2024-517234-18-00